EU clinical trial 2024-517851-11-00: A prospective, single-center phase I pilot study to assess the tissue activity of multidrug resistance-associated protein 1 with positron emission tomography
Sponsor: Medical University Of Vienna (Educational Institution). Phase: Human Pharmacology (Phase I)- First administration to humans. Countries: Austria (ongoing, recruiting).
Therapeutic area(s): Analytical, Diagnostic and Therapeutic Techniques and Equipment [E] - Diagnosis [E01]; Diseases [C] - Nervous System Diseases [C10]
Gender: Female, Male. Age: 18-64 years, 65+ years. Enrolment: 40.
Status: Ongoing, recruiting. Start date (EU): 2022-09-05. Decision date: 2025-01-17. Results received: No. Last updated: 2025-01-17.

Condition(s): Investigation in healthy volunteers and Alzheimer's disease patients

Source: https://euclinicaltrials.eu/ctis-public/view/2024-517851-11-00